EU clinical trial 2024-518984-36-00: Optimizing the antibiotic treatment of uncomplicated acute appendicitis: a prospective randomized multicenter study
Sponsor: Turku University Hospital (Hospital/Clinic/Other health care facility). Phase: Therapeutic use (Phase IV). Countries: Finland (authorised, recruitment pending).
Therapeutic area(s): Diseases [C] - Digestive System Diseases [C06]
Gender: Female, Male. Age: 18-64 years. Enrolment: 599.
Status: Authorised, recruitment pending. Decision date: 2024-11-20. Results received: No. Last updated: 2024-11-20.

Condition(s): Uncomplicated acute appendicitis
Product: LEVOFLOXACIN, ERTAPENEM, MOXIFLOXACIN, METRONIDAZOLE

Primary endpoint: The primary endpoint of the APPAC II trial is defined as the success of the randomised treatment at one-year follow-up (treatment efficacy). Treatment success in both groups is defined as the resolution of acute appendicitis with antibiotic treatment resulting in discharge from the hospital without the need for surgical intervention and no recurrent appendicitis during a follow-up of one year.
Endpoint(s): Secondary endpoints include post-intervention complications (possible postoperative complications classified using the Clavien-Dindo classification), late recurrence (after one year) of acute appendicitis after antibiotic treatment, duration of hospital stay, VAS scores, quality of life (QOL, using for example 5D or 15D validated QOL questionnaire), length of sick leave and treatment costs.

Source: https://euclinicaltrials.eu/ctis-public/view/2024-518984-36-00